EU clinical trial 2023-510427-29-00: A Phase 2 Open-Label Study of Continuation Treatment with Combination Pyrimidine Nucleosides in Patients with Thymidine Kinase 2 Deficiency (TK2)
Protocol code: TK0102
Sponsor: UCB Biosciences Inc. (Pharmaceutical company). Phase: Therapeutic exploratory (Phase II). Countries: Spain (ongoing, recruitment ended).
Therapeutic area(s): Diseases [C] - Musculoskeletal Diseases [C05]
Gender: Female, Male. Age: 0-17 years, 18-64 years, 65+ years. Enrolment: 23.
Status: Ongoing, recruitment ended. Start date (EU): 2019-09-04. Decision date: 2024-06-07. Results received: No. Last updated: 2026-05-11.

Condition(s): Thymidine kinase 2 deficiency
Product: doxecitine and doxribtimine

Primary endpoint: Incidence of treatment-emergent adverse events (TEAEs), Incidence of TEAEs leading to study drug withdrawal
Endpoint(s): Clinical Global Impression of Improvement (CGI-I) Response score, Mean minimum plasma concentration (Cmin) of deoxycytidine (dC) and deoxythymidine (dT) at steady state, Mean maximum plasma concentration (Cmax) of dC and dT at steady state, Mean area under the plasma concentration - time curve from time 0 to 24 hours (AUC0-24) of dC and dT at steady state

Source: https://euclinicaltrials.eu/ctis-public/view/2023-510427-29-00